EU clinical trial 2024-511651-17-00: A phase II multicenter single-armed study using subject-specific minimal residual minimal disease markers to adopt treatment after allogeneic stem cell transplantation for subjects with myleodysplastic syndrome - MDS
Sponsor: Karolinska University Hospital (Hospital/Clinic/Other health care facility). Phase: Therapeutic exploratory (Phase II). Countries: Sweden (ongoing, recruiting), Norway (ongoing, recruiting), Finland (ongoing, recruiting), Denmark (ongoing, recruiting).
Therapeutic area(s): Diseases [C] - Hemic and Lymphatic Diseases [C15]
Gender: Female, Male. Age: 18-64 years, 65+ years. Enrolment: 200.
Status: Ongoing, recruiting. Start date (EU): 2021-09-21. Decision date: 2024-03-15. Results received: No. Last updated: 2026-05-27.
Decision dates by country: NO: 2024-03-20, FI: 2024-03-15, DK: 2025-01-07, SE: 2024-03-15

Condition(s): Myelodysplastic syndrome
Product: AZACITIDINE

Primary endpoint: The percentage of clinical events defined as relapse or non-relapse death at 12 months from verified MRD positivity (NMDSG14B Part 2 compared to Part 1)
Endpoint(s): MRD positive cohort: Relapse-free survival, MRD positive cohort: GVHD and relapse-free survival, MRD positive cohort: Proportion of MRD positive subjects achieving MRD-negativity, MRD positive cohort: Incidence and severity of GVHD, MRD positive cohort: Safety in MRD positive subjects subjected to MRD-guided clinical intervention, Whole study cohort: Relapse-free survival, Whole study cohort: GVHD and relapse-free survival, Whole study cohort: Incidence and severity of GVHD, Whole study cohort: Overall survival

Source: https://euclinicaltrials.eu/ctis-public/view/2024-511651-17-00